EU clinical trial 2024-515574-27-00: LONGITUDINAL STUDY OF THE POSITRON EMISSION TOMOGRAPHY (PET) TRACER FOR TAU 18F-PI-2620 IN INDIVIDUALS WITH DOWN SYNDROME
Protocol code: IIBSP-FPI-2019-108
Sponsor: Fundacio Institut De Recerca De L'Hospital De La Santa Creu I Sant Pau (Hospital/Clinic/Other health care facility). Phase: Therapeutic exploratory (Phase II). Countries: Spain (ongoing, recruiting).
Therapeutic area(s): Analytical, Diagnostic and Therapeutic Techniques and Equipment [E] - Diagnosis [E01]
Gender: Female, Male. Age: 18-64 years, 65+ years. Enrolment: 80.
Status: Ongoing, recruiting. Start date (EU): 2024-07-03. Decision date: 2024-07-03. Results received: No. Last updated: 2025-06-19.

Condition(s): Down Syndrome, Alzheimer disease
Product: [18F]PI-2620

Primary endpoint: The primary efficacy variable of the study, at both measurement time points, will be the Standardized Uptake Value Ratio (SUVR) from images generated with 18F-PI-2620 (images will be obtained between 0-90 minutes post-administration; the cerebellum will be used as the reference region), as a measure of tau protein aggregates in the brain., In addition to efficacy data, adverse effects will be recorded during the 24 hours following administration.

Source: https://euclinicaltrials.eu/ctis-public/view/2024-515574-27-00